EU clinical trial 2023-505844-21-00: An open-label, multiple dose, multicenter study to evaluate the pharmacokinetics, safety, and tolerability of filgotinib in children and adolescents from 8 to less than 18 years of age with juvenile idiopathic arthritis
Protocol code: GLPG-0634-CL-131
Sponsor: Alfasigma S.p.A. (Pharmaceutical company). Phase: Human Pharmacology (Phase I)- Other. Countries: France (ended), Germany (ended), Poland (ended), Spain (ended).
Therapeutic area(s): Diseases [C] - Skin and Connective Tissue Diseases [C17]
Gender: Female, Male. Age: 0-17 years. Enrolment: 50.
Status: Ended. Start date (EU): 2024-02-14. End date (EU): 2026-06-17. End date: 2026-06-17. Decision date: 2024-01-15. Results received: No. Last updated: 2026-07-20.
Decision dates by country: FR: 2024-01-17, PL: 2024-01-19, ES: 2024-01-22, DE: 2024-01-15

Condition(s): juvenile idiopathic arthritis
Product: Jyseleca 200 mg film-coated tablets, GLPG0634, Jyseleca 100 mg film-coated tablets

Primary endpoint: PK parameters of filgotinib and its major metabolite GS-829845 (including maximum observed plasma concentration at steady state [Cmax,ss], area under the plasma concentration-time curve over the dosing interval at steady state [AUC0-24,ss], and area under the plasma concentration-time curve over the dosing interval at steady state for the effective exposure [AUCeff,ss]).
Endpoint(s): Frequency and severity of treatment-emergent adverse events (TEAEs), TEAEs of interest, serious TEAEs, and TEAEs leading to treatment discontinuation., Acceptability of the commercially developed film-coated tablets and of the minitablets as measured by the Pediatric Oral Medicine Acceptability Questionnaire for Patients (POMAQ-P).

Source: https://euclinicaltrials.eu/ctis-public/view/2023-505844-21-00